EU clinical trial 2024-517766-41-00: Pancreatic cancer first-line NALIRIFOX optimization with 5-FU maintenance and role of antibiotics and microbiota exploration in second-line treatment – A non-comparative, randomized phase II PANORAMIX GERCOR G-116 PRODIGE 105 study
Protocol code: PANORAMIX G-116
Sponsor: Association Gercor (Laboratory/Research/Testing facility). Phase: Therapeutic exploratory (Phase II). Countries: France (ongoing, recruiting).
Therapeutic area(s): Diseases [C] - Digestive System Diseases [C06]
Gender: Female, Male. Age: 18-64 years, 65+ years. Enrolment: 142.
Status: Ongoing, recruiting. Start date (EU): 2026-02-17. Decision date: 2025-05-27. Results received: No. Last updated: 2025-05-27.

Condition(s): Patients with metastatic pancreatic ductal adenocarcinoma.
Product: OXALIPLATINE ACCORD 5 mg/ml, solution à diluer pour perfusion, ELVORINE 100 mg/10 mL, solution injectable, Gemcitabine100 mg/ml Concentrate for Solution for Infusion, CIPROFLOXACINE ARROW 500 mg, comprimé pelliculé sécable, Fluorouracil 50 mg/ml Solution for Injection or Infusion, Onivyde pegylated liposomal 4.3 mg/ml concentrate for dispersion for infusion, PACLITAXEL ARROW 6 mg/ml, solution à diluer pour perfusion, pharmaceutical microcrystalline cellulose

Primary endpoint: STEP 1 The 6-month PFS post R1 in patients with L1 NALIRIFOX followed by LV5FU2 (5-FU/LV) in Arm 1A defined by the number of patients free of radiological progression or death at 6 post R1 divided by the total number of patients assessable for the PFS status at 6 months., STEP 2: The 6-month OS of L2 in Arm 2A (gemcitabine-based chemotherapy combination with ciprofloxacin) post R2, defined by the number of patients alive at 6 months divided by the total number of patients assessable for the OS status at 6 months.
Endpoint(s): STEP 1: The 6-month PFS rate of standard NALIRIFOX in Arm 1B, defined by the number of patients free of radiological progression or death at 6 months post R1 divided by the total number of patients assessable for the PFS status at 6 months, STEP 1 : PFS-L1 in Arm 1A and in Arm 1B, defined as the time between the date of R1 and the date of the first documented disease progression (PD; per RECIST 1.1) determined by the Investigator or death due to any cause, whichever occurs first, STEP 1 : OS-R1 in Arm 1A and in Arm 1B, defined as the time between the date of R1 and the date of death from any cause, STEP 1 :ORR-L1 at 4 months of L1 in Arm 1A and in Arm 1B, defined as the number of patients with a response of complete response (CR) or partial response (PR) divided by the number of patients with measurable target lesion at baseline, STEP 1 : ORR-RI in Arm 1A, defined as the number of patients with CR or PR divided by the number of patients with measurable target lesions at baseline, STEP 1 : BRR-L1 in Arm 1A and in Arm 1B, defined as the best response designation, recorded between the date of R1 and the date of objectively documented PD (per RECIST 1.1) or the date of subsequent anti-cancer therapy, whichever occurs first, STEP 1 : BRR-L1R in Arm 1A, defined as the best response designation, recorded between the date of reintroduction of NALIRIFOX and the date of objectively documented PD post NALIRIFOX reintroduction (per RECIST 1.1), STEP 1 : DDC in Arm 1A and in Arm 1B, STEP 1 : Only grade 3-4 AEs/SAEs related to treatment according to the NCI CTCAE v 5.0, STEP 1: The rate of peripheral neuropathy, STEP 1 : HRQoL (EORTC QLQ-C30 [Appendix 25.2] and EORTC QLQ-PAN26 in Arm 1A and in Arm 1B, Step 2 : OS-R2 in in Arm 2A and Arm 2B, defined as the time between the date of R2 and the date of death from any cause, Step 2 : PFS-L2 according to RECIST 1.1 in Arm 2A and Arm 2B, defined as the time from R2 to the date of the first documented PD (per RECIST 1.1) determined by the Investigator or death due to any cause, whichever occurs first, STEP 2 : ORR-L2 in Arm 2A and Arm 2B, defined as the number of patients with CR/PR divided by the number of patients with measurable target lesions at baseline., STEP 2 : BRR-L2 of L2 in Arm 2A and Arm 2B, defined as the best response designation (CR/PR/SD), recorded between the date of R2 and the date of objectively documented PD (per RECIST 1.1) or the date of subsequent anti-cancer therapy, whichever occurs first, STEP 2 : All grade AEs and severe (grade 3-5) AEs in Arm 2A and Arm 2B, according to the NCI CTCAE v 5.0, STEP2 : The rate (percentage) of occurrence of MRB, STEP 2 : The pharmacokinetics of gemcitabine clearance and gemcitabine’s metabolite, dFdU, between Arm 2A and Arm 2B

Source: https://euclinicaltrials.eu/ctis-public/view/2024-517766-41-00